EU clinical trial 2024-517336-21-00: Prospective, randomized, double-blind, placebo-controlled, single-center comparative trial evaluating oral Istradefylline 40 mg once daily for reducing microglial activation in the brain of patients with progressive multiple sclerosis (MS)
Sponsor: University Of Turku (Educational Institution). Phase: Therapeutic exploratory (Phase II). Countries: Finland (ongoing, recruiting).
Therapeutic area(s): Diseases [C] - Immune System Diseases [C20]; Diseases [C] - Nervous System Diseases [C10]
Gender: Female, Male. Age: 18-64 years. Enrolment: 34.
Status: Ongoing, recruiting. Start date (EU): 2025-03-31. Decision date: 2024-11-15. Results received: No. Last updated: 2026-08-05.

Condition(s): Progressive multiple sclerosis
Product: Placebo tablets will be white, round, flat, scored tablet, 9 mm in diameter sourced from Yliopiston Apteekki, ISTRADEFYLLINE

Primary endpoint: The change in proportion of active voxels in supratentorial cerebral white matter in the end-of-treatment TSPO-PET images vs. baseline TSPO-PET images in participants with progressive MS treated with istradefylline vs. placebo
Endpoint(s): Change in number of TSPO-PET–measurable chronic active lesions, Change in proportion of TSPO-PET–detectable active voxels at the rim of chronic lesions (change in proportion of active voxels), Change in proportion of TSPO-PET–detectable active voxels in the NAWM (change in proportion of active voxels), Change in TSPO-PET signal (DVR, distribution volume ratio) at the rim of chronic lesions, Change in DVR in the NAWM, Change in QSM-positive iron rim lesions, Change in MRI volumetric measures in the brain regions of interest, Change in T1 and T2 lesion burden using MRI, Change in neuroaxonal damage measured by DTI-MRI parameters, Change in disease worsening measured using the Timed 25 Foot Walk, Change in hand dexterity measured using the 9-Hole Peg Test, Change in functional Systems and Expanded Disability Status Scale, Change in cognition measured using neuropsychological evaluation, Change in health-related quality of life measured using the RAND 36-Item Health Survey and Multiple Sclerosis Impact Scale questionnaires, Change in fatigue measured using the Modified Fatigue Impact Scale and Fatigue Severity Scale questionnaires, Change in blood serum neurofilament light chain and glial fibrillary acdic protein levels

Source: https://euclinicaltrials.eu/ctis-public/view/2024-517336-21-00